EU clinical trial 2026-525176-26-00: Study to Learn How Safe EV25 is and the Amount of EV25 in the Body Over a Period of Time, When Given as a Single Dose to Adult Healthy People [CCI]
Protocol code: EV-FLU-CL-BR01
Sponsor: Eradivir Inc. (Pharmaceutical company). Phase: Human Pharmacology (Phase I)- Other. Countries: Belgium (ended).
Therapeutic area(s): Diseases [C] - Virus Diseases [C02]
Gender: Female, Male. Age: 18-64 years, 65+ years. Enrolment: 16.
Status: Ended. Start date (EU): 2026-05-28. End date (EU): 2026-07-06. Decision date: 2026-04-30. Results received: No. Last updated: 2026-05-19.

Condition(s): Influenza

Source: https://euclinicaltrials.eu/ctis-public/view/2026-525176-26-00